EU clinical trial 2024-520276-10-00: A double-blind, randomized, placebo-controlled, multicenter trial evaluating the efficacy and safety of Saccharomyces boulardii CNCM I-745 in adult patients with non-constipated Irritable Bowel Syndrome.
Protocol code: BoWell - Sb252
Sponsor: Biocodex (Pharmaceutical company). Phase: Therapeutic confirmatory (Phase III). Countries: Portugal (ongoing, recruiting), Spain (ongoing, recruiting).
Therapeutic area(s): Diseases [C] - Digestive System Diseases [C06]
Gender: Female, Male. Age: 18-64 years, 65+ years. Enrolment: 365.
Status: Ongoing, recruiting. Start date (EU): 2025-09-04. Decision date: 2025-08-07. Results received: No. Last updated: 2026-07-16.
Decision dates by country: ES: 2025-09-09, PT: 2025-08-07

Condition(s): Non-constipated Irritable Bowel Syndrome (IBS)
Product: LOPERAMIDE, Ultra-Levura 250 mg cápsulas duras, Placebo to Saccharomyces boulardii

Primary endpoint: Absolute change from baseline in IBS-SSS total score at 8 weeks (day 56 (D56)).
Endpoint(s): Absolute change from baseline in Irritable Bowel Syndrome-Quality of Life (IBS- QOL) score at D56 and D84., Absolute change from baseline in IBS-SSS total score at D28 and D84. Absolute change from baseline in IBS-SSS subscores (abdominal pain, number of days with pain, abdominal distension, satisfaction with bowel habits, impact on life in general) at D56 and D84., Proportion of responders defined as patients who improved ≥ 50 points on IBS-SSS at D28, D56 and D84 compared with baseline., Proportion of responders at D56 and D84 according to the EMA definition (patients with a subject’s global assessment of efficacy scale (IBS-GIS) of the highest two improvement grades of a 7-point scale, and with an abdominal pain score which has improved at least 30% compared to baseline). The abdominal pain score will be taken from the abdominal pain 11-point NRS., Adverse events and serious adverse events (number of events and number of participants with at least one event), changes in vital signs, body weight (quantitative statistics at each assessment time and changes from baseline), or resulting in the discontinuation of the study treatment.

Source: https://euclinicaltrials.eu/ctis-public/view/2024-520276-10-00